EU clinical trial 2024-511407-42-00: A Phase 2 Open-Label, Multicenter Clinical Study of The Safety, Efficacy, Pharmacokinetic, and Pharmacodynamic Profiles of CGT9486 as a Single Agent in Patients with Advanced Systemic Mastocytosis
Protocol code: CGT9486-20-201
Sponsor: Cogent Biosciences Inc. (Pharmaceutical company). Phase: Therapeutic exploratory (Phase II). Countries: Spain (ongoing, recruitment ended), France (ongoing, recruitment ended), Netherlands (ongoing, recruitment ended), Norway (ongoing, recruitment ended), Belgium (ended), Austria (ongoing, recruitment ended), Italy (ongoing, recruitment ended), Poland (ongoing, recruitment ended), Germany (ongoing, recruitment ended).
Therapeutic area(s): Diseases [C] - Neoplasms [C04]
Gender: Female, Male. Age: 18-64 years, 65+ years. Enrolment: 60.
Start date (EU): 2022-01-10. Decision date: 2024-06-06. Results received: No. Last updated: 2026-08-08.
Decision dates by country: ES: 2024-06-07, BE: 2024-06-07, PL: 2024-06-21, AT: 2024-06-11, NO: 2024-06-06, NL: 2024-06-06, FR: 2024-06-12, IT: 2024-07-03, DE: 2024-06-24

Condition(s): Advanced Systemic Mastocytosis
Product: CGT9486, CGT9486

Primary endpoint: Part 1: Dose Optimization - Safety assessments and dose modifications; - PK and pharmacodynamic assessments; - Overall response rate (ORR), Part 2 Stage 1: Dose Confirmation - Safety assessments and dose modifications - PK and pharmacodynamic assessments - Overall response rate (ORR), Part 2 Stage 2: Expansion - Overall response rate (ORR)
Endpoint(s): Part 1 and Part 2: Incidence of AEs, SAEs, AEs leading to dose modifications, and changes from baseline in laboratory results, Part 1 and Part 2: Duration Of Response (DOR), Time to Response (TTR), Progression Free Survival (PFS), Overall Survival (OS), Pure Pathologic Response (PPR), Part 1 and Part 2: Changes in the levels of serum tryptase, Part 1 and Part 2: Changes in the levels of KIT D816V mutation allele burden in blood and bone marrow, Part 1 and Part 2: Change in pathologic findings in the blood and bone marrow including mast cell infiltration, monocytosis, and eosinophilia, Part 1 and Part 2: Plasma concentrations of bezuclastinib, Part 1 and Part 2: Change from baseline in PGIS, PGIC, MC-QoL and MAS

Source: https://euclinicaltrials.eu/ctis-public/view/2024-511407-42-00